EU clinical trial 2024-516161-36-00: Ibuprofen 200 mg bioequivalence study
Protocol code: 983/24
Sponsor: Patheon Softgels B.V. (Pharmaceutical company). Phase: Human Pharmacology (Phase I)- Bioequivalence Study. Countries: Czechia (ended).
Therapeutic area(s): Diseases [C] - Musculoskeletal Diseases [C05]
Gender: Female, Male. Age: 18-64 years. Enrolment: 24.
Status: Ended. Start date (EU): 2024-09-13. End date (EU): 2024-11-06. Decision date: 2024-09-10. Results received: No. Last updated: 2024-11-26.

Condition(s): not applicable (submitted trial is BE)

Source: https://euclinicaltrials.eu/ctis-public/view/2024-516161-36-00